EU clinical trial 2023-505530-10-00: Long-term Follow-up Study for Participants Previously Treated with Ciltacabtagene Autoleucel
Protocol code: 68284528MMY4002
Sponsor: Janssen - Cilag International (Pharmaceutical company). Phase: Therapeutic use (Phase IV). Countries: Spain (ongoing, recruiting), Netherlands (ongoing, recruiting), Belgium (ongoing, recruiting), France (ongoing, recruiting).
Therapeutic area(s): Diseases [C] - Neoplasms [C04]
Gender: Female, Male. Age: 18-64 years, 65+ years. Enrolment: 55.
Status: Ongoing, recruiting. Start date (EU): 2022-09-14. Decision date: 2023-10-17. Results received: No. Last updated: 2026-01-28.
Decision dates by country: FR: 2024-05-07, BE: 2023-10-20, ES: 2023-10-18, NL: 2023-10-17

Condition(s): Multiple Myeloma
Product: CARVYKTI 3.2 × 10^6 – 1.0 × 10^8 cells dispersion for infusion

Primary endpoint: Number of subjects with delayed adverse events associated with administration of Cilta-cel. The following adverse events will be collected: - New malignancies and recurrence of preexisting malignancy (all grades), - New incidence or exacerbation of a preexisting neurologic disorder (all grades), - New incidence or exacerbation of a preexisting rheumatologic or other autoimmune disorder (all grades), - New incidence of Grade ≥3 hematologic disorder including hypogammaglobulinemia (Years 1-5).Serious hematologic disorder including hypogammaglobulinemia (Years 6-15)., - New incidence of Grade ≥3 infection (Years 1-5).Serious infection(Years 6-15)., - All SAEs (Years 1-5). Only related SAEs as assessed by the Investigator (Years 6-15).
Endpoint(s): - Number of subjects with measurable RCL in peripheral blood., - Number of subjects with CAR transgene level >lower limit of quantitation (LLOQ) in peripheral blood cells., - Assessment of the pattern of lentiviral vector integration sites if at least 1% of cells in the blood sample or new malignancy are positive for vector sequences., - Long term follow-up on CAR-T therapy efficacy if the subject does not have confirmed disease progression or does not initiate subsequent antimyeloma therapy at the entry of the study and at any time of during the study., - Overall Survival (OS)

Source: https://euclinicaltrials.eu/ctis-public/view/2023-505530-10-00